EU clinical trial 2023-510190-34-00: A Phase 3b, open-label study to evaluate the non-inferiority of the immune response and to evaluate the safety of the RSVPreF3 OA investigational vaccine in adults 18-49 years of age at increased risk of respiratory syncytial virus disease, compared to older adults ≥60 years of age.
Protocol code: 222253
Sponsor: GlaxoSmithKline Biologicals (Pharmaceutical company). Phase: Therapeutic confirmatory (Phase III). Countries: Germany (ended).
Therapeutic area(s): Diseases [C] - Respiratory Tract Diseases [C08]; Diseases [C] - Virus Diseases [C02]
Gender: Female, Male. Age: 18-64 years, 65+ years. Enrolment: 70.
Status: Ended. Start date (EU): 2024-06-04. End date (EU): 2025-03-13. End date: 2025-03-18. Decision date: 2024-05-24. Results received: Yes. Last updated: 2025-01-31.

Condition(s): Respiratory Syncytial Virus Infections
Product: Arexvy powder and suspension for suspension for injection Respiratory Syncytial Virus (RSV) vaccine (recombinant, adjuvanted)

Primary endpoint: "• RSV-A neutralizing titers expressed as GMT ratio (RSV-OA over RSV-A-AIR) at 1 month (Day 31) after study intervention administration. • Seroresponse in RSV-A neutralizing titers from Day 1 to Day 31.", "• RSV-B neutralizing titers expressed as GMT ratio (RSV-OA over RSV-A-AIR) at 1 month (Day 31) after study intervention administration. • Seroresponse in RSV-B neutralizing titers from Day 1 to Day 31. "
Endpoint(s): "• Occurrence of each solicited administration site event with onset within 4 days after dosing • Occurrence of each solicited systemic event with onset within 4 days after study intervention administration • Occurrence of unsolicited AEs within 30 days after study intervention administration • Occurrence of all SAEs (including fatal and related SAEs) and AESIs after study intervention administration (Day 1) up to study end (Month 6). ", "• RSV-A and RSV-B neutralizing titers, at pre-study intervention administration and 1 month and 6 months after study intervention administration. "

Source: https://euclinicaltrials.eu/ctis-public/view/2023-510190-34-00